EU clinical trial 2024-517684-23-00: Phase I/IIa study to test the safety and efficacy of MSC from umbilical cord tissue (UC-MSC) for the treatment of cartilage damage in the knee joint - BP CC 001
Sponsor: BIONCaRT GmbH (Pharmaceutical company). Phase: Phase I and Phase II (Integrated)- First administration to humans. Countries: Germany (ongoing, recruiting).
Therapeutic area(s): Diseases [C] - Musculoskeletal Diseases [C05]; Analytical, Diagnostic and Therapeutic Techniques and Equipment [E] - Therapeutics [E02]
Gender: Female, Male. Age: 18-64 years. Enrolment: 55.
Status: Ongoing, recruiting. Start date (EU): 2025-10-23. Decision date: 2025-04-24. Results received: No. Last updated: 2026-02-20.

Condition(s): Cartilage defect of the knee joint
Product: BP CC 001

Primary endpoint: Proportion of patients with a serious adverse event within 24 months after surgery
Endpoint(s): Regeneration of damaged cartilage measured by MOCART score (relative change in the value 12 months after surgery compared to the initial value before surgery), Relative change in knee joint pain 12 and 24 months after the surgery compared to the baseline value before the surgery measured using the KOOS Pain Subscore, Relative change in knee-related quality of life 12 and 24 months after surgery compared to baseline before surgery measured by KOOS-QoL subscore, Relative change in symptoms and stiffness 12 and 24 months after surgery compared to pre-surgery baseline as measured by KOOS symptom subscore, Relative change in activities of daily life 12 and 24 months after surgery compared to baseline before surgery measured by KOOS-ADL subscore, Relative change in physical resilience during sporting activities 12 and 24 months after the surgery compared to the baseline value before the surgery measured by KOOS-Excercise /Rec-Subscore, AE, AR, SAE, SAR, SUSAR: Description of all adverse events (AE, AR, SAE, SAR, SUSAR) within 24 months after surgery in terms of severity (assessed according to National Cancer Institute - Common Terminology Criteria for Adverse Events Version 5.0 (NCI-CTCAE V 5.0)), causality, outcome

Source: https://euclinicaltrials.eu/ctis-public/view/2024-517684-23-00